EU clinical trial 2024-517112-30-00: Filgotinib bridging in newly diagnosed rheumatoid arthritis patients (FAST RA trial); A pragmatic randomized controlled non-inferiority low intervention clinical trial
Protocol code: 2024-517112-30-00
Sponsor: Medisch Spectrum Twente (Hospital/Clinic/Other health care facility). Phase: Therapeutic use (Phase IV). Countries: Netherlands (authorised, recruitment pending).
Therapeutic area(s): Analytical, Diagnostic and Therapeutic Techniques and Equipment [E] - Therapeutics [E02]
Gender: Female, Male. Age: 18-64 years. Enrolment: 168.
Status: Authorised, recruitment pending. Decision date: 2025-01-16. Results received: No. Last updated: 2025-01-16.

Condition(s): Rheumatoid arthritis
Product: Kenacort-A 40, suspensie voor injectie 40 mg/ml, Jyseleca 200 mg film-coated tablets

Primary endpoint: The primary endpoint of this study is the percentage of rheumatoid arthritis patients in remission (DAS28-CRP < 2,6) at three months.
Endpoint(s): Disease activity remission at 6, 9 and 12 months, Disease activity scores and components at 3, 6, 9, and 12 months, Changes in biomarkers: CRP and ESR, Time to diseases activity remission and remission duration, Patient-reported outcome measures, Adherence to treatment, Patient satisfaction, Adverse events: incidence and severity (side effects), Direct and indirect costs, The cumulative dosage of corticosteroids over the study period, The cumulative usage of bDMARDs over the study period

Source: https://euclinicaltrials.eu/ctis-public/view/2024-517112-30-00